EU clinical trial 2025-523396-38-00: Multicentre, open-label, phase 1/2 study of LB-208, selective antagonist of the serotonin 5-hydroxytryptamine receptor 1B (HTR1B), in adults with relapse or refractory (r/r) acute myeloid leukaemia (AML) and r/r higher-risk (HR) myelodysplastic syndrome (MDS)
Protocol code: LB208-1-002
Sponsor: Aop Orphan Pharmaceuticals GmbH (Pharmaceutical company). Phase: Phase I and Phase II (Integrated)- Other. Countries: Spain (ongoing, recruiting).
Therapeutic area(s): Diseases [C] - Neoplasms [C04]
Gender: Female, Male. Age: 18-64 years, 65+ years. Enrolment: 60.
Status: Ongoing, recruiting. Start date (EU): 2026-05-29. Decision date: 2026-04-15. Results received: No. Last updated: 2026-07-09.

Condition(s): Relapse or refractory (r/r) acute myeloid leukaemia (AML) and r/r higher-risk (HR) myelodysplastic syndrome (MDS)
Product: LB-208, LB-208

Primary endpoint: Safety, and toxicity will be described by observed frequency and severity graded using the National Cancer Institute Common Terminology Criteria for Adverse Events (NCI CTCAE), version 5.0., including dose limiting toxicity (DLT) rate, adverse events (AEs), serious adverse events (SAEs), and AEs leading to discontinuation.
Endpoint(s): Plasma concentration-time profiles, and PK parameters of LB-208., Response according to the revised European LeukemiaNet (ELN) Response Criteria in AML (Döhner et al., 2022) and revised International Working Group 2023 (IWG 2023) in HR-MDS (Zeidan, Platzbecker, et al., 2023). Response for all patients will be assessed by the site Investigators.

Source: https://euclinicaltrials.eu/ctis-public/view/2025-523396-38-00